EU clinical trial 2022-500752-39-00: A Phase 3, Multicenter, Randomized, Partially Blinded, Palivizumab-Controlled Study to Evaluate the Safety, Efficacy, and Pharmacokinetics of MK-1654 in Infants and Children at Increased Risk for Severe RSV Disease
Protocol code: MK-1654-007
Sponsor: Merck Sharp & Dohme LLC (Pharmaceutical company). Phase: Therapeutic confirmatory (Phase III). Countries: Germany (ended), Spain (ended), Hungary (ended), Finland (ended), France (ended), Norway (ended), Greece (ended), Czechia (ended), Italy (ended).
Therapeutic area(s): Diseases [C] - Virus Diseases [C02]
Gender: Female, Male. Age: 0-17 years. Enrolment: 317.
Status: Ended. Start date (EU): 2021-11-25. End date (EU): 2025-06-02. End date: 2025-10-16. Decision date: 2023-05-22. Results received: Yes. Last updated: 2025-06-04.
Decision dates by country: NO: 2023-06-09, ES: 2023-05-30, FR: 2023-05-25, HU: 2023-05-22, GR: 2023-06-20, IT: 2023-06-22, CZ: 2023-06-14, FI: 2023-05-22, DE: 2023-05-26

Condition(s): Prevention of Respiratory syncytial virus (RSV) infection in infants and children at increased risk for severe RSV disease
Product: Clesrovimab, Synagis 100 mg/1 ml solution for injection, Placebo to MK-1654 - Saline for injection, Isotone Natriumchloridlösung 0,9 % Braun Injektionslösung

Primary endpoint: Percentage of participants with solicited injection-site Adverse Events (AEs) in respiratory syncytial virus (RSV) Season 1, Percentage of participants with solicited daily body temperature with fever in RSV Season 1, Percentage of participants with solicited systemic AEs in RSV Season 1, Percentage of participants with anaphylaxis/hypersensitivity AEs of special interest (AESI) in RSV Season 1, Percentage of participants with rash AESI in RSV Season 1, Percentage of participants with non-serious AEs in RSV Season 1, Percentage of participants with serious AEs (SAEs) through the duration of participation in RSV Season 1
Endpoint(s): Percentage of participants with RSV-associated medically attended lower respiratory infection (MALRI) in RSV Season 1, Percentage of participants with RSV-associated hospitalization in RSV Season 1, Percentage of participants with solicited injection-site AEs in RSV Season 2, Percentage of participants with solicited daily body temperature with fever in RSV Season 2, Percentage of participants with solicited systemic AEs in RSV Season 2, Percentage of participants with anaphylaxis/hypersensitivity AESI in RSV Season 2, Percentage of participants with rash AESI in RSV Season 2, Percentage of participants with non-serious AEs in RSV Season 2, Percentage of participants with SAEs through 180 days postdose in RSV Season 2, Serum concentration of clesrovimab (MK-1654) after dose of clesrovimab in RSV Season 1, Serum concentration of clesrovimab after dose of clesrovimab in RSV Season 2

Source: https://euclinicaltrials.eu/ctis-public/view/2022-500752-39-00